EU clinical trial 2023-505558-16-00: A Phase 3b, Open-label Study to Evaluate the Effectiveness and Safety of Lebrikizumab Treatment in Adults and Adolescents with Moderate-to-Severe Atopic Dermatitis
Protocol code: M-17923-33
Sponsor: Almirall S.A. (Pharmaceutical company). Phase: Therapeutic confirmatory (Phase III). Countries: Germany (ended), Netherlands (ended).
Therapeutic area(s): Diseases [C] - Skin and Connective Tissue Diseases [C17]
Gender: Female, Male. Age: 0-17 years, 18-64 years, 65+ years. Enrolment: 218.
Status: Ended. Start date (EU): 2023-10-24. End date (EU): 2025-06-16. End date: 2025-06-18. Decision date: 2023-10-11. Results received: Yes. Last updated: 2025-04-01.
Decision dates by country: NL: 2024-06-03, DE: 2023-10-11

Condition(s): Atopic Dermatitis
Product: Lebrikizumab

Primary endpoint: Percentage of participants achieving EASI score ≤7 at Week 24
Endpoint(s): 1. Percentage of participants achieving EASI score ≤7, EASI ≤5, and EASI ≤3 by visit, 2. Percentage of participants achieving EASI 75, and EASI 90 by visit, 3. Percentage of participants with an IGA score of 0 or 1 and a reduction ≥2 points by visit, 4. Percentage of participants achieving SCORAD 75 and SCORAD 90 by visit, 5. Percentage change from baseline in mTLSS (hands) from baseline by visit, 6. Percentage of participants with a Face IGA score of 0 or 1 and a reduction ≥2 points by visit, 7. Percentage of participants with Pruritus NRS ≥4 at baseline achieving ≥4-point improvement in Pruritus NRS from baseline by visit, 8. Percentage of participants achieving DLQI 0-1 by visit, 9. Percentage of participants with DLQI ≥4 at baseline achieving ≥4-point improvement in DLQI from baseline by visit, 10. Percentage of participants achieving cDLQI 0-1 by visit, 11. Percentage of participants with cDLQI ≥6 at baseline achieving ≥6-point improvement in cDLQI from baseline by visit, 12. Percentage of participants with a Sleep-Loss Scale of ≥2 points at baseline who achieve at least 2-point reduction by visit, 13. Percentage of participants with POEM ≥4 at baseline achieving ≥4-point improvement in POEM from baseline by visit, 14. Itch Controlled Days questionnaire score by visit, 15. TSQM-9 by visit

Source: https://euclinicaltrials.eu/ctis-public/view/2023-505558-16-00